EU clinical trial 2024-515604-39-00: SPLASH: Study Evaluating Metastatic Castrate Resistant Prostate Cancer Treatment Using 177Lu-PNT2002 PSMA Therapy After Second-line Hormonal Treatment
Protocol code: PBP-301
Sponsor: Point Biopharma Inc. (Pharmaceutical company). Phase: Therapeutic confirmatory (Phase III). Countries: Sweden (ongoing, recruitment ended), Netherlands (ended), France (ongoing, recruitment ended).
Therapeutic area(s): Diseases [C] - Neoplasms [C04]
Gender: Male. Age: 18-64 years, 65+ years. Enrolment: 65.
Start date (EU): 2022-01-28. Decision date: 2024-11-26. Results received: No. Last updated: 2025-12-15.
Decision dates by country: NL: 2024-11-27, FR: 2024-11-26, SE: 2024-11-27

Condition(s): Metastatic castration-resistant prostate cancer (mCRPC)
Product: ABIRATERONE, 177Lu-PNT2002, GALLIUM (68GA) GOZETOTIDE, ENZALUTAMIDE

Primary endpoint: Radiological progression-free survival (rPFS) assessed by Blinded Independent Central Review (BICR) using Response Evaluation Criteria in Solid Tumors (RECIST) 1.1 (soft tissue) and Prostate Cancer Working Group 3 (PCWG3) (bone) criteria.
Endpoint(s): 1. ORR: proportion of patients with partial or complete response (PR or CR, respectively) by BICR based on RECIST 1.1 criteria (soft tissue) and PCWG3 criteria (bone). Duration of response: time from the first date of CR or PR by BICR to the first occurrence of PD by BICR based on PCWG3-modified RECIST 1.1 or death in the absence of progression., 2. Overall survival (OS): time from randomization to date of death from any cause., 3. Time from randomization to first symptomatic skeletal-related event., 4. PSA response rate according to PCWG3 criteria (first occurrence of a 50% or more decline in PSA from baseline, confirmed by a second measurement at least 3 wk later). Biochemical PFS: time from randomization to the date of the first PSA increase from baseline ≥25% and ≥2 ng/mL above nadir confirmed by a 2nd PSA measurement defining progression ≥3 wk later per PCWG3., 5. Safety Endpoints: • Frequency and severity of adverse events and serious adverse events using CTCAE v. 5.0. • Changes from baseline in physical exam findings, vital signs, clinical laboratory values, and electrocardiogram (ECG) values. • Number of patients discontinuing study drug due to adverse events.

Source: https://euclinicaltrials.eu/ctis-public/view/2024-515604-39-00